EU clinical trial 2023-506126-36-00: A monocentric Phase I pivotal pharmacology study for the determination of the local and systemic exposure of locally applied Minocycline in periodontal pockets via a newly developed pharmaceutical formulation for the treatment of patients with recurrent or persistent periodontitis
Protocol code: MinoPro-101
Sponsor: PerioTrap Pharmaceuticals GmbH (Pharmaceutical company). Phase: Human Pharmacology (Phase I)- Other. Countries: Germany (authorised, recruitment pending).
Therapeutic area(s): Diseases [C] - Stomatognathic Diseases [C07]; Phenomena and Processes [G] - Microbiological Phenomena [G06]; Diseases [C] - Bacterial Infections and Mycoses [C01]
Gender: Female, Male. Age: 18-64 years, 65+ years. Enrolment: 24.
Status: Authorised, recruitment pending. Decision date: 2023-10-16. Results received: No. Last updated: 2023-10-31.

Condition(s): Periodontitis

Source: https://euclinicaltrials.eu/ctis-public/view/2023-506126-36-00